EU clinical trial 2024-513574-21-00: A Phase I First Time in Human Open Label Study of GSK3745417 Administered With and Without Anticancer Agents in Participants With Advanced Solid Tumors
Protocol code: 208850
Sponsor: Glaxosmithkline Research & Development Limited (Pharmaceutical company). Phase: Human Pharmacology (Phase I)- First administration to humans. Countries: Spain (ended), France (ended).
Therapeutic area(s): Diseases [C] - Neoplasms [C04]
Gender: Female, Male. Age: 18-64 years, 65+ years. Enrolment: 62.
Status: Ended. Start date (EU): 2019-08-09. End date (EU): 2026-01-09. End date: 2026-01-10. Decision date: 2024-06-26. Results received: No. Last updated: 2025-12-03.
Decision dates by country: FR: 2024-07-01, ES: 2024-06-26

Condition(s): Neoplasms

Source: https://euclinicaltrials.eu/ctis-public/view/2024-513574-21-00